EU clinical trial 2024-518012-39-00: A Study to Assess Adverse Events and Change in Disease Activity of Intravenously (IV) Infused ABBV-324 in Compared to Oral Lenvatinib Capsules in Adult Participants With Hepatocellular Cancer (HCC) or Squamous-Cell Non-Small Cell Lung Cancer (LUSC)
Protocol code: M25-292
Sponsor: AbbVie Deutschland GmbH & Co. KG (Pharmaceutical company). Phase: Human Pharmacology (Phase I)- First administration to humans. Countries: Spain (ongoing, recruitment ended).
Therapeutic area(s): Diseases [C] - Neoplasms [C04]
Gender: Female, Male. Age: 18-64 years, 65+ years. Enrolment: 20.
Status: Ongoing, recruitment ended. Start date (EU): 2025-09-22. Decision date: 2025-09-09. Results received: No. Last updated: 2026-05-20.

Condition(s): Squamous-Cell Non-Small Cell Lung Cancer, Hepatocellular Cancer

Source: https://euclinicaltrials.eu/ctis-public/view/2024-518012-39-00